EU clinical trial 2024-515123-11-00: A Phase I, Open-Label Study to Evaluate the Safety, Tolerability, Pharmacokinetics, and Preliminary Efficacy of HMPL-523 in Patients with Relapsed or Refractory Lymphoma
Protocol code: 2018-523-00US1
Sponsor: Hutchmed Ltd. (Pharmaceutical company). Phase: Human Pharmacology (Phase I)- Other. Countries: Poland (ended).
Therapeutic area(s): Diseases [C] - Neoplasms [C04]
Gender: Female, Male. Age: 18-64 years, 65+ years. Enrolment: 14.
Status: Ended. Start date (EU): 2019-09-05. End date (EU): 2025-02-26. End date: 2025-02-26. Decision date: 2024-11-11. Results received: No. Last updated: 2024-11-11.

Condition(s): Lymphoma

Source: https://euclinicaltrials.eu/ctis-public/view/2024-515123-11-00